EU clinical trial 2023-506637-30-00: The AGAINST-PLD; An investigator-driven, randomized, open label clinical trial assessing efficacy of leuprorelin to halt disease progression in PLD
Protocol code: 202000894
Sponsor: Universitair Medisch Centrum Groningen (Hospital/Clinic/Other health care facility). Phase: Therapeutic confirmatory (Phase III). Countries: Netherlands (ended).
Therapeutic area(s): Diseases [C] - Congenital, Hereditary, and Neonatal Diseases and Abnormalities [C16]
Gender: Female. Age: 18-64 years. Enrolment: 36.
Status: Ended. End date (EU): 2025-04-30. Decision date: 2024-11-27. Results received: Yes. Last updated: 2024-11-27.

Condition(s): polycystic liver disease
Product: LEUPRORELIN

Primary endpoint: The primary outcome variable is liver growth rate (in % per year), calculated over the first 18 months of the trial (screening-18 months) based on liver volumes measured on MRI, comparing the direct start group and delayed start group.
Endpoint(s): Polycystic liver disease related complaints, using the validated PLD Questionnaire. The change in the score on the PLD Questionnaire will be compared between patients in the direct start group and the delayed start group after 18 months of treatment., Liver growth rate (in % per year) compared within individuals before start of treatment and during treatment., (Severe) Adverse events

Source: https://euclinicaltrials.eu/ctis-public/view/2023-506637-30-00